EU clinical trial 2024-512754-16-01: A Phase 3, Multicenter, Open-label Study to Test the Diagnostic Performance of Copper Cu 64 PSMA I&T PET/CT in Staging of Men with Newly Diagnosed Unfavorable Intermediate-risk, High-risk or Very High-risk Prostate Cancer Electing to Undergo Radical Prostatectomy with Pelvic Lymph Node Dissection
Protocol code: CURCu64PSM0003
Sponsor: Curium US LLC (Pharmaceutical company). Phase: Therapeutic confirmatory (Phase III). Countries: France (ended), Spain (ended), Italy (ended).
Therapeutic area(s): Diseases [C] - Male Urogenital Diseases [C12]
Gender: Male. Age: 18-64 years, 65+ years. Enrolment: 150.
Status: Ended. End date (EU): 2025-02-04. Decision date: 2025-01-15. Results received: No. Last updated: 2025-01-20.
Decision dates by country: IT: 2025-01-20, ES: 2025-01-15, FR: 2025-01-15

Condition(s): Prostate cancer
Product: 64Cu-PSMA I&T

Primary endpoint: 1. The sensitivity of copper Cu 64 PSMA I&T PET/CT to determine the presence of metastatic pelvic lymph nodes relative to histopathology reference standard. At least one positive pelvic lymph node on the PET scan and one positive lymph node as determined by histopathology on the same side of the pelvis (left or right) will be counted a true positive at the patient level., 2. The specificity of copper Cu 64 PSMA I&T PET/CT to determine the absence of metastatic pelvic lymph nodes relative to histopathology reference standard. Negative pelvic lymph node on the PET scan and negative pelvic lymph nodes as determined by histopathology on the same side of the pelvis (Left or Right) will be counted a true negative at the patient level.
Endpoint(s): 1. Reader kappa statistics of copper Cu 64 PSMA I&T PET/CT scan interpretation by the blinded independent readers., 2. Treatment-emergent adverse events from the time of IP administration up to 72 hours.

Source: https://euclinicaltrials.eu/ctis-public/view/2024-512754-16-01